EU clinical trial 2024-514821-45-00: Phase II trial exploring combined neoadjuvant therapy with Pembrolizumab/Lenvatinib and adjuvant Pembrolizumab in patients with surgically resectable Non-Small- Cell Lung Cancer (NSCLC)
Protocol code: INNWOP2020
Sponsor: Medizinische Universitaet Innsbruck (Educational Institution). Phase: Therapeutic exploratory (Phase II). Countries: Austria (ongoing, recruiting).
Therapeutic area(s): Diseases [C] - Respiratory Tract Diseases [C08]
Gender: Female, Male. Age: 18-64 years, 65+ years. Enrolment: 33.
Status: Ongoing, recruiting. Start date (EU): 2021-05-12. Decision date: 2024-09-08. Results received: No. Last updated: 2024-09-08.

Condition(s): Non-Small-Cell Lung Cancer
Product: KEYTRUDA 25 mg/mL concentrate for solution for infusion, Lenvatinib, Lenvatinib

Primary endpoint: Achievment of major pathological response after neoadjuvant immunotherapy in combination with angiogenesis inhibition
Endpoint(s): Radiologic response according to RECIST/iRECIST, Surgical resection rate, Disease free survival at 1, 2, 3 and 5 years, Overall survival at 1, 2, 3 and 5 years, Feasibility and safety of a neoadjuvant/adjuvant treatment

Source: https://euclinicaltrials.eu/ctis-public/view/2024-514821-45-00